EU clinical trial 2024-517224-19-00: A drug-drug interaction trial in healthy female participants to investigate the effect of aprocitentan on combined hormonal contraceptives.
Protocol code: ID-080-111
Sponsor: Idorsia Pharmaceuticals Ltd. (Pharmaceutical company). Phase: Human Pharmacology (Phase I)- Other. Countries: Czechia (ended).
Therapeutic area(s): Not possible to specify
Gender: Female. Age: 18-64 years, 65+ years. Enrolment: 19.
Status: Ended. Start date (EU): 2025-01-06. End date (EU): 2025-02-21. End date: 2025-02-22. Decision date: 2024-12-10. Results received: No. Last updated: 2024-12-10.

Condition(s): Not applicable - healthy volunteer trial

Source: https://euclinicaltrials.eu/ctis-public/view/2024-517224-19-00